EU clinical trial 2024-511557-21-00: A Randomized, Double-blind, Multicenter, Placebo-controlled Study to Evaluate the Efficacy, Safety, and Tolerability of Aticaprant 10 mg as Adjunctive Therapy in Adult Participants with Major Depressive Disorder (MDD) with Moderate-to-severe Anhedonia and Inadequate Response to Current Antidepressant Therapy and an Open-label Long-term Extension Treatment with Aticaprant
Protocol code: 67953964MDD3007
Sponsor: Janssen Cilag International (Pharmaceutical company). Phase: Therapeutic confirmatory (Phase III). Countries: Belgium (ended), Bulgaria (ended), Poland (ended), Sweden (ended), Hungary (ended), Czechia (ended), Spain (ended), Finland (ended).
Therapeutic area(s): Psychiatry and Psychology [F] - Mental Disorders [F03]
Gender: Female, Male. Age: 18-64 years. Enrolment: 212.
Status: Ended. Start date (EU): 2024-11-14. End date (EU): 2025-02-28. End date: 2025-04-24. Decision date: 2024-10-28. Results received: Yes. Last updated: 2024-11-06.
Decision dates by country: BE: 2024-10-31, BG: 2024-11-04, CZ: 2024-11-01, HU: 2024-10-28, ES: 2024-10-28, SE: 2024-10-29, PL: 2024-10-31, FI: 2024-11-06

Condition(s): Major Depressive Disorder (MDD) with Moderate-to-severe Anhedonia
Product: Matching placebo tablet, JNJ-67953964

Primary endpoint: Change from baseline to Day 43 in the Montgomery-Åsberg Depression Rating Scale (MADRS) total score

Source: https://euclinicaltrials.eu/ctis-public/view/2024-511557-21-00